EU clinical trial 2024-512486-14-00: A Phase 3, Double-Blind, Randomized, Parallel-Group, Placebo-Controlled, Multicenter Trial to Confirm the Efficacy and Safety of Glepaglutide 10 mg Twice-Weekly, Followed by a Long-Term, Open-Label Safety Evaluation in Patients with Short Bowel Syndrome–Intestinal Failure (SBS-IF)
Protocol code: ZP1848-23029
Sponsor: Zealand Pharma A/S (Pharmaceutical company). Phase: Therapeutic confirmatory (Phase III). Countries: Finland (authorised, recruiting), France (ongoing, recruiting), Belgium (authorised, recruiting), Germany (ongoing, recruiting), Hungary (authorised, recruiting), Spain (ongoing, recruiting), Austria (authorised, recruiting), Netherlands (authorised, recruiting), Italy (authorised, recruiting), Denmark (authorised, recruiting), Czechia (not authorised), Norway (authorised, recruiting), Poland (ongoing, recruiting), Sweden (ongoing, recruiting), Estonia (authorised, recruitment pending).
Therapeutic area(s): Diseases [C] - Digestive System Diseases [C06]
Gender: Female, Male. Age: 18-64 years, 65+ years. Enrolment: 75.
Start date (EU): 2026-01-22. Decision date: 2025-12-04. Results received: No. Last updated: 2026-07-23.
Decision dates by country: CZ: 2025-12-12, NL: 2025-12-09, DK: 2025-12-08, SE: 2025-12-09, IT: 2025-12-16, AT: 2025-12-18, NO: 2025-12-08, FI: 2025-12-16, HU: 2025-12-18, DE: 2025-12-08, ES: 2025-12-15, EE: 2026-07-23, FR: 2025-12-04, BE: 2025-12-05, PL: 2025-12-22

Condition(s): Short Bowel Syndrome
Product: Placebo for glepaglutide, Glepaglutide 20.0 mg/mL

Primary endpoint: 1. Change in weekly PS volume from baseline to Week 24
Endpoint(s): 1. Reduction of at least 20% in weekly PS volume from baseline to Week 52, 2. Reduction in days on PS ≥1 day/week from baseline to Week 52, 3. Reduction of 100% weekly PS volume (weaned-off) from baseline to Week 52, 4. Achieving ‘much better’ PGIC status at Week 24, 5. Clinical response, defined as achieving at least 20% reduction in weekly PS volume from baseline to both Week 20 and Week 24, 6. Reduction in days on PS ≥1 day/week from baseline to Week 24, 7. Reduction of 100% weekly PS volume (weaned-off) from baseline to Week 24, 8. Change in weekly PS volume from baseline to Week 12, 9. Change in weekly PS volume from baseline to Week 8, 10. TEAEs from baseline to Week 52

Source: https://euclinicaltrials.eu/ctis-public/view/2024-512486-14-00